EU clinical trial 2023-503677-37-00: A Phase 2, open-label, multi-center, 2-stage sequential cohort, dose escalation study to assess the safety, tolerability, pharmacokinetics, pharmacodynamics, and efficacy of subcutaneous SAR442501 in pediatric participants with Achondroplasia
Protocol code: DRI16646
Sponsor: Sanofi-Aventis Recherche & Developpement (Pharmaceutical company). Phase: Therapeutic exploratory (Phase II). Countries: Italy (ended), Spain (ended), Czechia (ended).
Therapeutic area(s): Diseases [C] - Congenital, Hereditary, and Neonatal Diseases and Abnormalities [C16]
Gender: Female, Male. Age: 0-17 years. Enrolment: 12.
Status: Ended. Start date (EU): 2023-10-24. End date (EU): 2024-12-12. End date: 2025-02-12. Decision date: 2023-09-22. Results received: Yes. Last updated: 2024-10-30.
Decision dates by country: IT: 2023-09-22, CZ: 2023-09-22, ES: 2023-09-26

Condition(s): Osteochondrodysplasia

Primary endpoint: Number of participants with adverse events (AE), serious adverse events (SAE), and adverse events of special interest (AESI) during the treatment-emergent period
Endpoint(s): Change in annualized growth velocity (AGV) Z-score, Change in AGV (cm/year), Change in height Z score, Change in upper-to-lower body segment ratio, Change in upper to lower extremity ratio, Change in sitting to standing height ratio (crown-to-rump length to total length for infants), Change in arm span to height ratio, Change in upper arm to forearm length ratio, Change in upper leg to lower leg ratio, Change in head circumference to height ratio, Change in brainstem parameter, Change in skull parameter, Change in spine morphometric parameter, Change in volumetric parameter, Change in overall health-related quality of life score in the PedsQL Inventory Generic Core Scale, Change in fatigue score in the PedsQL Multidimensional Fatigue Scale, Change in present pain and worst pain rating (PPQ) score, Change in mobility and symptom rating (STEMS) score, Change in developmental score in the Achondroplasia Developmental Recording Form, Assessment of pharmacokinetic (PK) parameter: plasma concentration of SAR442501, Assessment of PK parameter: maximum plasma concentration observed (Cmax), Assessment of PK parameter: time to reach Cmax (Tmax), Assessment of PK parameter: Area under the plasma concentration versus time curve calculated using the trapezoidal method during a dose interval (AUC0-t), Assessment of PK parameter: concentration observed before treatment administration during repeated dosing (Ctrough), Assessment of pharmacodynamics (PD) parameter: change in collagen X biomarker (CXM) levels, Assessment of PD parameter: change in osteocalcin levels, Assessment of PD parameter: change in bone-specific alkaline phosphatase, Assessment of PD parameter: change in procollagen type 1 N-terminal propeptide (P1NP) levels, Assessment of PD parameter: change in collagen-type 1 C-Telopeptide (CTX) levels, Number of participants with treatment-emergent anti-drug antibodies (ADA), Changes in neurological examination

Source: https://euclinicaltrials.eu/ctis-public/view/2023-503677-37-00